EU clinical trial 2025-523657-34-00: J3R-MC-YDAG - A Phase 3 Randomized, Double-Blind, Placebo-Controlled Study to Investigate the Efficacy and Safety of Once Weekly Eloralintide in Adult Participants With Obesity or Overweight, Without Type 2 Diabetes
Protocol code: J3R-MC-YDAG
Sponsor: Eli Lilly & Co. (Pharmaceutical company). Phase: Therapeutic confirmatory (Phase III). Countries: Germany (ongoing, recruiting), Poland (ongoing, recruiting), Belgium (ongoing, recruiting).
Therapeutic area(s): Diseases [C] - Nutritional and Metabolic Diseases [C18]
Gender: Female, Male. Age: 18-64 years, 65+ years. Enrolment: 254.
Status: Ongoing, recruiting. Start date (EU): 2026-04-13. Decision date: 2026-03-27. Results received: No. Last updated: 2026-06-10.
Decision dates by country: BE: 2026-03-31, PL: 2026-04-03, DE: 2026-03-27

Condition(s): Obesity, Overweight
Product: Eloralintide, Eloralintide, Eloralintide, Placebo to match LY, Eloralintide

Primary endpoint: Percent Change from Baseline in Body Weight [Time Frame: Baseline, Week 64

Source: https://euclinicaltrials.eu/ctis-public/view/2025-523657-34-00